EU clinical trial 2024-517036-21-00: Multicenter randomized controlled trial of the value of intravitreal anti-VEGF injections as initial then adjuvant treatment in Coats' disease
Protocol code: FME_2018_9
Sponsor: Fondation A De Rothschild (Hospital/Clinic/Other health care facility). Phase: Therapeutic exploratory (Phase II). Countries: France (ended).
Therapeutic area(s): Diseases [C] - Eye Diseases [C11]
Gender: Female, Male. Age: 0-17 years. Enrolment: 30.
Status: Ended. Start date (EU): 2024-11-06. End date (EU): 2026-01-28. Decision date: 2024-11-06. Results received: Yes. Last updated: 2024-11-06.

Condition(s): Coats' disease
Product: Avastin 25 mg/ml concentrate for solution for infusion.

Primary endpoint: Proportion of patients with improvement in at least one stage of the disease according to the Shields classification (Am J Ophthalmol, 2001), 6 months after initiation of study treatment
Endpoint(s): Comparison, between the 2 groups, of the proportion of patients with an improvement of at least one stage of the Shields classification assessed on multimodal retinal imaging by two independent experts at 2 months, 4 months and 9 months after initiation of study treatment, Comparison between the 2 groups of each of the items defining the Shields stage at 2, 4, 6 and 9 months after initiation of study treatment: presence of telangiectasia, presence of exudates, presence of retinal detachment; glaucoma, bulbar phthisis, Comparison between the 2 groups of visual acuity (expressed in logMAR) at 4, 6, and 9 months after initiation of study treatment, in children of verbal age (from 3 years), Comparison between the 2 groups of macular thickness variation (in micrometers), the presence of serous detachment, and the maximum thickness of fibrosis observed on optical coherence tomography at 2, 4, 6, and 9 months after initiation of study treatment in children for whom it was performed, Comparison between the 2 groups in terms of the number of patients requiring additional treatment (i.e., an additional laser session beyond the third session or surgical treatment) 9 months after initiation of study treatment, Comparison between the 2 groups in terms of the number of events and adverse effects (i.e., progression to stage 5 (phthisis); need for surgical treatment; cataract; vitreoretinal fibrosis; tractional retinal detachment, as well as any serious adverse event detected by the investigator leading to discontinuation of treatment), Calculation of the kappa coefficient, measuring the agreement between the two independent expert ophthalmologist evaluators at each evaluation of Coats disease stage at 0, 1, 2, 4, 6, and 9 months after initiation of study treatment

Source: https://euclinicaltrials.eu/ctis-public/view/2024-517036-21-00